EU clinical trial 2023-509874-48-00: An open label, balanced, randomized, two-treatment, two-period, two-sequence, single-dose, crossover, bioequivalence study comparing Dextroamphetamine Saccharate, Amphetamine Aspartate, Dextroamphetamine Sulfate and Amphetamine Sulfate Tablets (Mixed Salts of Single Entity Amphetamine Product) 30 mg, manufactured by Frontida Biopharm. Inc., Philadelphia, USA with Attent 30 mg (Mixed Amphetamine Salts tablets) manufactured by Teva Israel Ltd., in healthy adult, human subjects under fasting condition.
Protocol code: DEADA-07-23
Sponsor: Sun Pharmaceutical Industries Limited (Pharmaceutical company). Phase: Human Pharmacology (Phase I)- Bioequivalence Study. Countries: Romania (ended).
Therapeutic area(s): Psychiatry and Psychology [F] - Mental Disorders [F03]
Gender: Female, Male. Age: 18-64 years. Enrolment: 28.
Status: Ended. Start date (EU): 2025-01-09. End date (EU): 2025-01-30. Decision date: 2024-05-09. Results received: No. Last updated: 2024-05-09.

Condition(s): ADHD

Source: https://euclinicaltrials.eu/ctis-public/view/2023-509874-48-00